EU clinical trial 2024-510888-39-00: AHEAD 3-45 Study: A Placebo-Controlled, Double-Blind, Parallel Treatment Arm, 216 Week Study with an Extension Phase to Evaluate Efficacy and Safety of Treatment With BAN2401 in Subjects With Preclinical Alzheimer’s Disease and Elevated Amyloid (A45 Trial) and in Subjects With Early Preclinical Alzheimer’s Disease and Intermediate Amyloid (A3 Trial)
Protocol code: BAN2401-G000-303
Sponsor: Eisai Limited (Pharmaceutical company). Phase: Therapeutic confirmatory (Phase III). Countries: Spain (ongoing, recruitment ended).
Therapeutic area(s): Diseases [C] - Nervous System Diseases [C10]
Gender: Female, Male. Age: 18-64 years, 65+ years. Enrolment: 20.
Status: Ongoing, recruitment ended. Start date (EU): 2021-07-21. Decision date: 2024-06-06. Results received: No. Last updated: 2026-07-05.

Condition(s): Preclinical Alzheimer’s Disease and Elevated Amyloid, Early Preclinical Alzheimer’s Disease and Intermediate Amyloid
Product: LECANEMAB

Primary endpoint: A45 Trial: Change from baseline in PACC5 at 216 weeks., A3 Trial: Change from baseline in amyloid PET SUVr at 216 weeks.
Endpoint(s): A45 Trial: Change from baseline in amyloid PET SUVr at 96 and 216 weeks, A45 Trial: Change from baseline in tau PET SUVr at 96 and 216 weeks, A45 Trial: Change from baseline in CFI at 216 weeks, A3 Trial: Change from baseline in tau PET SUVr at 216 weeks

Source: https://euclinicaltrials.eu/ctis-public/view/2024-510888-39-00